EU clinical trial 2025-523760-21-00: A Study of GEN1106 in Participants with Solid Tumors
Protocol code: GCT1106-01
Sponsor: Genmab A/S (Pharmaceutical company). Phase: Human Pharmacology (Phase I)- First administration to humans. Countries: Spain (ongoing, recruiting).
Therapeutic area(s): Not possible to specify
Gender: Female, Male. Age: 18-64 years, 65+ years. Enrolment: 50.
Status: Ongoing, recruiting. Start date (EU): 2026-05-28. Decision date: 2026-04-27. Results received: No. Last updated: 2026-05-22.

Condition(s): Metastatic or advanced malignant solid tumors

Source: https://euclinicaltrials.eu/ctis-public/view/2025-523760-21-00